EU clinical trial 2024-518482-99-01: Personalized treatment aided by automated analysis of fluid in active neovascular age-related macular degeneration (nAMD) in a prospective, multicenter, randomized study
Sponsor: Medical University Of Vienna (Educational Institution). Phase: Therapeutic use (Phase IV). Countries: Austria (ongoing, recruiting).
Therapeutic area(s): Diseases [C] - Eye Diseases [C11]
Gender: Female, Male. Age: 18-64 years, 65+ years. Enrolment: 290.
Status: Ongoing, recruiting. Start date (EU): 2020-11-16. Decision date: 2025-01-15. Results received: No. Last updated: 2025-01-15.

Condition(s): neovasclar AMD
Product: Eylea 40 mg/mL solution for injection in a vial, Lucentis 10 mg/ml solution for injection in pre-filled syringe, Beovu 120 mg/ml solution for injection in pre-filled syringe

Primary endpoint: - Number of anti-VEGF injections
Endpoint(s): - Best-corrected visual acuity (BCVA) assessed by ETDRS Score, - Anatomic changes in the macula assessed with OCT (central retinal thickness, fluid volumes in nl, additional morphologic changes), - Formation of geographic-like macular atrophy assessed by fundus photography with special filters, - Formation of retinal tears assessed by OCT, - Chorioretinal perfusion changes (OCTA), - Perfusion of the neovascular lesion (OCTA, FA), - Changes in macular sensitivity (MP), - Assessment of fibrosis formation and deterioration of the retinal pigment epithelium (PS-OCT), - Quality-of-life assessed by questionnaire

Source: https://euclinicaltrials.eu/ctis-public/view/2024-518482-99-01